EU clinical trial 2023-503495-24-00: Safety, pharmacokinetics, and preliminary efficacy of VIR-5500 (AMX-500) in prostate cancer
Protocol code: VIR-5500-V101
Sponsor: Vir Biotechnology Inc. (Pharmaceutical company). Phase: Human Pharmacology (Phase I)- First administration to humans. Countries: Spain (ongoing, recruiting).
Therapeutic area(s): Diseases [C] - Neoplasms [C04]
Gender: Male. Age: 18-64 years, 65+ years. Enrolment: 106.
Status: Ongoing, recruiting. Start date (EU): 2023-10-30. Decision date: 2023-09-26. Results received: No. Last updated: 2026-08-05.

Condition(s): Hormone-refractory prostate cancer

Source: https://euclinicaltrials.eu/ctis-public/view/2023-503495-24-00